EU clinical trial 2024-510742-13-00: LOGGIC/FIREFLY-2: A Phase 3, Randomized, International Multicenter Trial of DAY101 Monotherapy Versus Standard of Care Chemotherapy in Patients with Pediatric Low-Grade Glioma Harboring an Activating RAF Alteration Requiring First-Line Systemic Therapy
Protocol code: DAY101-002
Sponsor: Day One Biopharmaceuticals Inc. (Pharmaceutical company). Phase: Therapeutic confirmatory (Phase III). Countries: Germany (ongoing, recruitment ended), Belgium (ongoing, recruitment ended), Denmark (ongoing, recruitment ended), Spain (ongoing, recruitment ended), France (ongoing, recruitment ended), Ireland (ongoing, recruitment ended), Hungary (ongoing, recruitment ended), Slovenia (ongoing, recruitment ended), Italy (ongoing, recruitment ended), Austria (ongoing, recruitment ended), Netherlands (ongoing, recruitment ended), Czechia (ongoing, recruitment ended), Norway (ongoing, recruitment ended), Sweden (ongoing, recruitment ended), Finland (ongoing, recruitment ended), Greece (ongoing, recruitment ended).
Therapeutic area(s): Diseases [C] - Neoplasms [C04]
Gender: Female, Male. Age: 0-17 years, 18-64 years. Enrolment: 245.
Status: Ongoing, recruitment ended. Start date (EU): 2023-04-19. Decision date: 2024-10-29. Results received: No. Last updated: 2026-03-23.
Decision dates by country: DK: 2024-11-04, ES: 2024-10-31, NL: 2024-10-29, SI: 2024-11-08, AT: 2024-11-05, HU: 2024-10-30, NO: 2024-10-30, IE: 2024-10-30, GR: 2024-12-09, BE: 2024-10-30, FR: 2024-11-13, IT: 2024-11-04, FI: 2024-10-30, SE: 2024-10-30, DE: 2024-11-05, CZ: 2024-10-31

Condition(s): Pediatric low-grade glioma harboring an activating RAF alteration requiring first-line systemic therapy
Product: Tovorafenib, VINCRISIN 1 mg/ml solution injectable, 2 mg, Carboplatin Hikma 10 mg/ml Konzentrat zur Herstellung einer Infusionslösung, Tovorafenib, VELBE 10 mg Trockensubstanz zur Injektionsbereitung, Vinblastin STADA 10 mg Pulver zur Herstellung einer Injektionslösung, cellcristin® 1 mg/ml Injektionslösung Wirkstoff: Vincristinsulfat, Vincristinesulfaat Teva 1 mg/ml, oplossing voor injectie, Vinblastinesulfaat 1 mg/ml PCH, oplossing voor injectie

Primary endpoint: ORR, per RAPNO criteria, defined as the proportion of patients with overall confirmed response of complete response (CR), partial response (PR), or minor response (MR).
Endpoint(s): PFS per RAPNO criteria, defined as time from randomization to progressive disease (PD) or death from any cause, whichever comes first., EFS per RAPNO criteria, defined as time from randomization to PD, death from any cause, or initiation of any new anticancer therapy, whichever comes first., OS, defined as time from randomization up to death from any cause.

Source: https://euclinicaltrials.eu/ctis-public/view/2024-510742-13-00